EU clinical trial 2023-505859-45-00: Double-Blind, Randomized, Placebo-Controlled Trial to Evaluate the Efficacy and Safety of Ilofotase Alfa in Patients at Risk for Renal Damage Following Open Heart Surgery.
Protocol code: AP-recAP-CSA-RD-0201
Sponsor: AM-Pharma B.V. (Pharmaceutical company). Phase: Therapeutic exploratory (Phase II). Countries: Germany (ended), Belgium (ended), Netherlands (ended).
Therapeutic area(s): Diseases [C] - Female Urogenital Diseases and Pregnancy Complications [C13]; Diseases [C] - Male Urogenital Diseases [C12]
Gender: Female, Male. Age: 18-64 years, 65+ years. Enrolment: 185.
Status: Ended. Start date (EU): 2023-12-19. End date (EU): 2025-12-03. End date: 2025-12-04. Decision date: 2023-12-08. Results received: Yes. Last updated: 2025-09-25.
Decision dates by country: NL: 2024-02-22, BE: 2023-12-12, DE: 2023-12-08

Condition(s): Risk for renal damage following open heart surgery
Product: Ilofotase alfa, Ilofotase alfa Placebo Drug Product

Primary endpoint: Ratio between the highest value post-surgery (post-surgery Day 1 and Days 2, 3, 4, and 5) and the pre-surgery baseline value for serum creatinine (sCreat)
Endpoint(s): Incidence rate of adverse events (AEs) and serious AEs through Day 28, Major adverse kidney events (MAKE) 60, defined as died up to and including Day 61, have received or are receiving new renal replacement therapy (RRT) up to and including Day 61, or have a decrease in estimated glomerular filtration rate (eGFR) ≥25% on Day 61 compared to the pre-surgery baseline eGFR reference value

Source: https://euclinicaltrials.eu/ctis-public/view/2023-505859-45-00